EU clinical trial 2025-522565-30-00: A single-centre, open-label, randomised, phase II study on the maintenance of ovulation inhibition after intentional application errors during 84 days of treatment with MR-130A-01 contraceptive transdermal patch
Protocol code: MR-130A-01-TD-2002
Sponsor: Mylan Pharmaceuticals Inc. (Pharmaceutical company). Phase: Therapeutic exploratory (Phase II). Countries: Germany (ongoing, recruitment ended).
Therapeutic area(s): Phenomena and Processes [G] - Reproductive and Urinary Physiological Phenomena [G08]
Gender: Female. Age: 18-64 years. Enrolment: 60.
Status: Ongoing, recruitment ended. Start date (EU): 2025-12-01. Decision date: 2025-11-17. Results received: No. Last updated: 2026-06-17.

Condition(s): Investigation of maintenance of ovulation inhibition after intentional application errors for indication of contraception in healthy subjects
Product: MR-130A-01

Primary endpoint: Ovulation incidence in cycles with regular application, in cycles with 24h application errors & in cycles with 48h application errors. Ovulation is defined as Hoogland-Skouby score 5 or 6 in combination with positive Landgren criterion (i.e., rupture, or development into a luteinized unruptured follicle, of a follicle like structure > 13 mm, with concomitant estradiol [E2] concentrations >100 pmol/L & followed by a luteal phase with progesterone [P] concentrations > 16.0 nmol/L during ≥ 5 days
Endpoint(s): • Ovulation incidence overall • Ovulation incidence per treatment cycle, HSS determined for each treatment cycle, Fulfilment of Landgren criterion in cycles with HSS 5 or 6, FLS diameter and endometrial thickness determined by Transvaginal Ultrasonography (TVUS), Pituitary (luteinizing hormone [LH]) and ovarian (estradiol [E2], progesterone [P]) hormone concentrations in serum, Plasma concentration of NGMN and its metabolite norgestrel determined: immediately (5min) before and at the end of one scheduled patch-free window (once each per 24/48-hour application-error cycle), and immediately (5min) before application of a new patch (trough, once per regular-application cycle), Plasma concentrations of NGMN and norgestrel, Assessment of adhesion score by the participants themselves and by the site personnel, Safety and tolerability: treatment-emergent Adverse Events (TEAE); safety clinical laboratory parameters; incidence of application site reactions (skin irritation scores assessed by the participants), Bleeding pattern determined as incidences of bleeding and/or spotting episodes, number of observed days of bleeding and/or spotting, bleeding only and spotting only, incidences of complete absence of bleeding or spotting (excluding the first episode)

Source: https://euclinicaltrials.eu/ctis-public/view/2025-522565-30-00